EU clinical trial 2023-509069-19-00: A randomized, double-blind, placebo-controlled, parallel-group, multicenter trial evaluating the efficacy and safety of 2 doses of buloxibutid over 52 weeks in people with idiopathic pulmonary fibrosis.
Protocol code: VP-C21-011
Sponsor: Vicore Pharma AB (Pharmaceutical company). Phase: Therapeutic exploratory (Phase II). Countries: Austria (ongoing, recruitment ended), Germany (ongoing, recruitment ended), Greece (ongoing, recruitment ended), Poland (ongoing, recruitment ended), Belgium (ongoing, recruitment ended), Italy (ongoing, recruitment ended).
Therapeutic area(s): Diseases [C] - Respiratory Tract Diseases [C08]
Gender: Female, Male. Age: 18-64 years, 65+ years. Enrolment: 94.
Status: Ongoing, recruitment ended. Start date (EU): 2024-12-12. Decision date: 2024-11-12. Results received: No. Last updated: 2026-06-30.
Decision dates by country: BE: 2024-11-12, IT: 2024-11-14, DE: 2024-11-13, GR: 2024-11-13, AT: 2024-11-18, PL: 2024-11-18

Condition(s): idiopathic pulmonary fibrosis
Product: Placebo to match buloxibutid oral capsules, Buloxibutid

Primary endpoint: Absolute change from baseline in FVC (mL) at Week 52
Endpoint(s): 1. Proportion of participants with an absolute FVC percent predicted (FVCpp) decrease from baseline ≥10%, a respiratory-related hospitalization or death, up to Week 52, 2. Annual rate of decline in FVC at Week 52 FVC analyses at Weeks 4, 12, 24, 36 and 52: • Absolute change from baseline in FVC (mL) • Absolute change from baseline in FVCpp • Proportion of participants with an absolute FVCpp increase of ≥5% from baseline • Proportion of participants with an absolute FVCpp increase of ≥10% from baseline, 3. Proportion of participants with an acute IPF exacerbation up to Week 52 • Time to first acute IPF exacerbation up to Week 52 • Proportion of participants with a respiratory-related hospitalization up to Week 52 • Number of respiratory-related hospitalizations up to Week 52 • Time to first respiratory-related hospitalizations up to Week 52, 4. Change from baseline in Living with Pulmonary Fibrosis (L-PF) total score, symptoms total score, impacts total score, and individual symptom domain scores (cough, dyspnea, and fatigue) at Weeks 4, 12, 24, 36 and 52 • Change from baseline in EuroQoL-5D 5 levels (EQ-5D-5L) health index value and visual analogue scale (VAS) score at Weeks 24 and 52, 5. Change from baseline in cough severity VAS score at Weeks 4, 12, 24, 36 and 52 • Change from baseline in PGI-S and PI-S of cough, shortness of breath and fatigue at Weeks 4, 12, 24, 36 and 52 • Proportion of participants with an improvement from baseline of at least 1 step on PGI-S and PI-S of cough, shortness of breath and fatigue at Weeks 4, 12, 24, 36 and 52 • PGI-C at Week 52, 6. Change from baseline in quantitative HRCT analysis parameters at Week 52 including lung volume, airway volume, fibrosis quantification and vascular quantification., 7. All-cause mortality up to Week 52, 8. The incidence, severity, outcome, and relationship to investigational medicinal product (IMP) for treatment-emergent adverse events (TEAEs) and serious adverse events (SAEs), and adverse events of special interest (AESIs) • Change from baseline in safety laboratory assessments, vital signs, and electrocardiograms (ECGs), 9. Plasma concentration of buloxibutid

Source: https://euclinicaltrials.eu/ctis-public/view/2023-509069-19-00